EU clinical trial 2024-515485-14-00: Study of four-factor prothrombin complex concentrate, OCTAPLEX, in patients with acute major bleeding on direct oral anticoagulant (DOAC) therapy with factor Xa inhibitor.
Protocol code: LEX-210
Sponsor: Octapharma AG (Pharmaceutical company). Phase: Therapeutic confirmatory (Phase III). Countries: Croatia (ended), Germany (ended), Poland (ended), Spain (ended), Italy (ended), Austria (ended).
Therapeutic area(s): Diseases [C] - Hemic and Lymphatic Diseases [C15]
Gender: Female, Male. Age: 18-64 years, 65+ years. Enrolment: 145.
Status: Ended. Start date (EU): 2022-07-07. End date (EU): 2026-02-25. End date: 2026-02-26. Decision date: 2024-08-22. Results received: No. Last updated: 2026-02-12.
Decision dates by country: HR: 2024-08-27, AT: 2024-11-29, PL: 2024-08-30, IT: 2024-09-24, ES: 2024-08-22, DE: 2024-08-26

Condition(s): Acute major bleeding in patients receiving DOAC therapy with factor Xa inhibitor
Product: Octaplex 500 I.E. Pulver und Lösungsmittel zur Herstellung einer Infusionslösung, Octaplex 1000 I.E. Pulver und Lösungsmittel zur Herstellung einer Infusionslösung

Primary endpoint: The proportion of patients in whom OCTAPLEX demonstrates haemostatic effectiveness, i.e., binary outcome of effective (rating of excellent or good) or non-effective (rating of poor/none) in management of major bleeding events.
Endpoint(s): Change in endogenous thrombin potential (ETP) as measured by thrombin generation assay (TGA) from baseline to 1 hour after OCTAPLEX administration, 30-day event rate of thromboembolic events (TEEs) and all-cause mortality, Occurrence of adverse events (AEs) during a 48-hours follow up period after OCTAPLEX administration, Vital signs and laboratory parameters during a 48-hours follow up period after OCTAPLEX administration

Source: https://euclinicaltrials.eu/ctis-public/view/2024-515485-14-00